EU clinical trial 2023-505297-15-00: A study to investigate the effects of multiple doses of obefazimod on a combined oral contraceptive (ethinyl estradiol/drospirenone) in healthy female participants of childbearing potential.
Protocol code: ABX464-910
Sponsor: Abivax (Pharmaceutical company). Phase: Human Pharmacology (Phase I)- Other. Countries: Belgium (ended).
Therapeutic area(s): Diseases [C] - Immune System Diseases [C20]
Gender: Female. Age: 18-64 years. Enrolment: 36.
Status: Ended. Start date (EU): 2023-10-10. End date (EU): 2024-08-31. Decision date: 2023-08-09. Results received: No. Last updated: 2024-07-17.

Condition(s): Healthy female participants of childbearing potential.

Source: https://euclinicaltrials.eu/ctis-public/view/2023-505297-15-00